EU clinical trial 2024-513969-39-00: Randomized, placebo-controlled, double-blind study to evaluate 2LPAPI® efficacy on the clearance of genital HR-HPV infections (PAPION study)
Protocol code: LLB-2017-01
Sponsor: Labo'Life Belgium (Pharmaceutical company). Phase: Therapeutic use (Phase IV). Countries: Belgium (ongoing, recruiting), Romania (ongoing, recruiting).
Therapeutic area(s): Diseases [C] - Female Urogenital Diseases and Pregnancy Complications [C13]
Gender: Female. Age: 18-64 years. Enrolment: 284.
Status: Ongoing, recruiting. Start date (EU): 2024-05-09. Decision date: 2024-05-08. Results received: No. Last updated: 2026-07-17.
Decision dates by country: RO: 2025-05-19, BE: 2024-05-08

Condition(s): Human Papillomavirus infection
Product: 2LPAPI granules en gélules à ouvrir, Placebo 2LPAPI

Primary endpoint: HR-HPV infection clearance at 12-month visit.
Endpoint(s): - HR-HPV infection clearance at 6-month visit; - HR-HPV infection clearance by HPV type at 6-month and 12-month visits; - Evolution of cytology (normalization, stagnation or aggravation) at 6-month and 12-month visits; - Normalization of cytology at 6-month and 12-month visits for the subpopulation of patients with a baseline non normal cytology, - Safety: adverse events (AEs) and serious adverse events (SAEs) considered as related or unrelated to the study drug.

Source: https://euclinicaltrials.eu/ctis-public/view/2024-513969-39-00